EU clinical trial 2024-518669-83-00: ICC APL STUDY 02 Treatment study for children and adolescents with Acute Promyelocytic Leukemia
Protocol code: ICC APL Study 02
Sponsor: Associazione Italiana Ematologia Oncologia Pediatrica (Hospital/Clinic/Other health care facility). Phase: Therapeutic exploratory (Phase II). Countries: Netherlands (ongoing, recruitment ended), Italy (ongoing, recruitment ended), Sweden (authorised, recruiting), Czechia (ongoing, recruitment ended), France (ongoing, recruitment ended).
Therapeutic area(s): Diseases [C] - Neoplasms [C04]
Gender: Female, Male. Age: 0-17 years. Enrolment: 99.
Start date (EU): 2024-12-05. Decision date: 2024-12-05. Results received: No. Last updated: 2026-04-29.
Decision dates by country: CZ: 2024-12-06, SE: 2024-12-05, FR: 2024-12-06, IT: 2025-01-21, NL: 2024-12-09

Condition(s): acute promyelocytic leukemia (APL) in children and adolescents
Product: ARACYTIN 100 mg/5 ml Polvere e Solvente per Soluzione Iniettabile, CYTARABINE ACCORD 20 mg/mL, solution injectable/pour perfusion, DEPO-MEDROL 40 mg/ml injekční suspenze, Metotressato Teva 25 mg/ml soluzione iniettabile, Arsenic trioxide Accord 1 mg/ml concentrate for solution for infusion, DEPO-MEDROL 40 mg/1 mL, suspension injectable en flacon, VESANOID 10 mg, capsule molle, METHOTREXATE ACCORD 25 mg/ml, solution injectable, Vesanoid 10 mg capsule molli, Vesanoid 10 mg mäkké kapsuly, TRISENOX 1 mg/ml concentrate for solution for infusion, SOLU MEDROL 500 mg/7,8 ml polvere e solvente per soluzione iniettabile, MYLOTARG 5 mg powder for concentrate for solution for infusion, Cytarabine Accord 100 mg/ml injekční/infuzní roztok, Methotrexat Accord 100 mg/ml koncentrát pro infuzní roztok

Primary endpoint: Event-free survival (EFS). This cumulative endpoint includes: no achievement of hematological complete remission after induction therapy; no achievement of molecular remission after three consolidation courses (molecular resistance); relapse (hematological/molecular); death, including early death, at 2 years from diagnosis. We aim at reaching a 3-year EFS probability of 90% (95% CI: 84.1-95.9%) and 80% (95% CI: 72.1-87.9%) in SR and HR patients, respectively
Endpoint(s): Rate of hematological CR after induction, Rate of early and aplastic death during induction, Overall survival (OS), Cumulative incidence of either hematological and molecular relapse (CIR), Incidence of hematological and non-hematological toxicity, Kinetics of MRD clearance, Rate of molecular remission after 3 consolidation cycles, Assessment of PML/RARα transcript level reduction during treatment, Toxicity - hematological and non-hematological, Supportive care requirements, Total hospitalization days during therapy and health economic impact

Source: https://euclinicaltrials.eu/ctis-public/view/2024-518669-83-00